EU clinical trial 2023-503394-37-00: MAGIC AML - Multiarm, Multicenter, RAndomized, Molecularly-GuIded Controlled Trial of Personalized Treatment Strategy - of Acute Myeloid Leukemia
Protocol code: 020520
Sponsor: Medical University Of Lodz (Educational Institution). Phase: Therapeutic confirmatory (Phase III). Countries: Poland (ongoing, recruiting).
Therapeutic area(s): Diseases [C] - Neoplasms [C04]
Gender: Female, Male. Age: 18-64 years, 65+ years. Enrolment: 520.
Status: Ongoing, recruiting. Start date (EU): 2024-10-23. Decision date: 2024-04-29. Results received: No. Last updated: 2026-07-24.

Condition(s): Acute Myeloid Leukemia
Product: CYTARABINE, DAUNORUBICIN, CLADRIBINE, Placebo 0mg, film-coated tablets, BIODRIBIN, 1 mg/ml, roztwór do infuzji, MYLOTARG 5 mg powder for concentrate for solution for infusion, MIDOSTAURIN, Venclyxto 100 mg film-coated tablets

Primary endpoint: Event Free Survival (EFS)
Endpoint(s): Complex complete remission with no measurable residual disease (CR+CRh+CRi MRD-), Overall survival (OS), Relapse-free survival (RFS), Cumulative Relapse Rate (CIR), Proportion of patients experiencing complete remission (CR), Proportion of Remission with partial haematological recovery (CRh) or remission with incomplete hematopoietic regeneration (CRi), Proportion of patients who did not achieve a response (NR), Percentage of patients experiencing early death (ED), Percentage of patients undergoing allogeneic transplantation, EORTC QLQ-C30 score, Proportion of patients experiencing a composite complete remission (cCR)

Source: https://euclinicaltrials.eu/ctis-public/view/2023-503394-37-00